EU clinical trial 2024-516543-26-00: A Multicenter, Multinational Extension of Study PRV-031-001 to Evaluate the Long-Term Safety of Teplizumab (PRV-031), a Humanized, FcR Non-Binding, Anti-CD3 Monoclonal Antibody, in Children and Adolescents with Recent-Onset Type 1 Diabetes Mellitus
Protocol code: PRV-031-003/LTS18119
Sponsor: Provention Bio Inc. (Pharmaceutical company). Phase: Therapeutic confirmatory (Phase III). Countries: Czechia (ongoing, recruitment ended), Belgium (ongoing, recruitment ended), France (ongoing, recruitment ended), Germany (ongoing, recruitment ended), Poland (ongoing, recruitment ended).
Therapeutic area(s): Diseases [C] - Nutritional and Metabolic Diseases [C18]
Gender: Female, Male. Age: 0-17 years, 18-64 years. Enrolment: 66.
Status: Ongoing, recruitment ended. Start date (EU): 2021-07-23. Decision date: 2024-10-10. Results received: No. Last updated: 2026-02-13.
Decision dates by country: FR: 2024-10-11, DE: 2024-10-16, CZ: 2024-10-11, BE: 2024-10-10, PL: 2024-10-16

Condition(s): Type 1 Diabetes Mellitus
Product: Teplizumab

Primary endpoint: Incidence of adverse events (AEs), serious adverse events (SAEs) and adverse events of special interest (AESIs), including infections and malignancies
Endpoint(s): The area under the time-versus-concentration curve (AUC) of C-peptide after a 4-hour (4h) mixed-meal tolerance test (MMTT), a measure of endogenous insulin production and β cell function by visit and change from baseline (MMTT), a measure of endogenous insulin production and β cell function, Insulin use, defined as a daily average dose in units per kilogram per day (U/kg/day) by visit and change from baseline, HbA1c levels(%) by visit and change from baseline

Source: https://euclinicaltrials.eu/ctis-public/view/2024-516543-26-00